EU clinical trial 2025-522560-32-01: A prospective, randomized, controlled clinical pilot trial investigating the partial down-titration of guideline-directed medical therapy in patients with heart failure in remission
Protocol code: Z-2025058
Sponsor: Ziekenhuis Oost Limburg (Hospital/Clinic/Other health care facility). Phase: Therapeutic use (Phase IV). Countries: Belgium (ongoing, recruiting).
Therapeutic area(s): Diseases [C] - Cardiovascular Diseases [C14]
Gender: Female, Male. Age: 18-64 years, 65+ years. Enrolment: 100.
Status: Ongoing, recruiting. Start date (EU): 2026-03-01. Decision date: 2025-11-10. Results received: No. Last updated: 2025-11-10.

Condition(s): Heart failure in remission
Product: LISINOPRIL EG 20 mg, comprimé sécable, Jardiance 10 mg film-coated tablets, BISOPROLOL EG 5 mg, comprimé sécable, Spironolactone 25mg Film-coated Tablets

Primary endpoint: Left ventricular remodeling, measured in a core echocardiography laboratory as an increase in left ventricular end-systolic volume index of more than 20% from baseline, NT-proBNP increase to more than 500 pg/mL, All-cause mortality
Endpoint(s): Time to first occurrence of all-cause mortality or all-cause hospitalizations, Change in KCCQ-12, Proportion of patients requiring HF treatment re-initiation or escalation (i.e., (re-)initation of at least one guideline-directed medical therapy or starting a loop diuretic)

Source: https://euclinicaltrials.eu/ctis-public/view/2025-522560-32-01